EU clinical trial 2022-500332-11-00: A Phase II, randomised, placebo-controlled, double-blind, parallel-group, efficacy and safety study of at least 48 weeks of oral BI 685509 treatment in adults with progressive systemic sclerosis
Protocol code: 1366-0031
Sponsor: Boehringer Ingelheim International GmbH, Boehringer Ingelheim RCV GmbH & Co. KG, Boehringer Ingelheim Espana S.A. (Pharmaceutical company). Phase: Therapeutic exploratory (Phase II). Countries: Spain (ended), Denmark (ended), France (ended), Austria (ended), Belgium (ended), Netherlands (ended), Romania (ended), Finland (ended), Sweden (ended), Portugal (ended), Germany (ended), Greece (ended), Italy (ended), Norway (ended), Czechia (ended), Poland (ended), Ireland (ended).
Therapeutic area(s): Diseases [C] - Skin and Connective Tissue Diseases [C17]
Gender: Female, Male. Age: 18-64 years. Enrolment: 68.
Status: Ended. Start date (EU): 2022-11-25. End date (EU): 2026-01-30. End date: 2026-01-31. Decision date: 2022-11-14. Results received: No. Last updated: 2025-09-15.
Decision dates by country: IT: 2022-11-16, ES: 2022-11-14, SE: 2022-11-15, GR: 2022-11-15, IE: 2022-11-16, BE: 2022-11-16, FI: 2022-11-16, DE: 2023-03-28, DK: 2022-11-15, PT: 2024-07-03, AT: 2022-11-16, FR: 2022-11-14, PL: 2022-11-16, NO: 2024-07-01, NL: 2022-11-16, RO: 2022-11-16, CZ: 2022-11-16

Condition(s): systemic sclerosis
Product: BI 685509, Placebo to BI 685509; Pharmaceutical form: film-coated tablets; Route of administration: oral., BI 685509, BI 685509

Primary endpoint: Rate of decline (mL) in forced vital capacity (FVC) over 48 weeks
Endpoint(s): Key secondary endpoint: Absolute change from baseline in mRSS at Week 48 in study participants with dcSSc, Key secondary endpoint: Proportion of responders in study participants with dcSSc based on the revised CRISS at Week 48 (Achievement of ≥ 20% improvement from baseline to Week 48 in at least 3 of the 5 core set measures, except ≥ 5% in FVC percent predicted, Key secondary endpoint: Absolute change from baseline in HAQ-DI score at Week 48, ACR-CRISS score at Week 48 in study participants with dcSSc, Absolute change from baseline in FVC (mL) at Week 48, Absolute change from baseline in FVC (% predicted) at Week 48, Absolute change from baseline in the PGA VAS score at Week 48, Absolute change from baseline in the CGA VAS score at Week 48, Composite measure of RP activity at Week 48, Absolute change from baseline in DU net burden at Week 48, Time to treatment failure, defined as the time to one of the following events (whichever occurs first) occurring over the 48-week and extended treatment period: - death, - absolute decline in percent-predicted FVC ≥10% relative to baseline, - ≥25% increase in mRSS and an increase in mRSS of >5 points, - initiation or dose change of immunomodulating/immunosuppressive therapy for clinically significant deterioration of SSc, Time to mRSS progression (≥25% increase in mRSS and an increase in mRSS of >5 points) in study participants with dcSSc, Proportion of study participants with dcSSc with mRSS progression (25% increase in mRSS and an increase in mRSS of >5 points)

Source: https://euclinicaltrials.eu/ctis-public/view/2022-500332-11-00